EU clinical trial 2025-521694-14-00: REstoration with calcifediol of VItamin D deficiency in pulmonary Arterial Hypertension patients (REVIDAH study)
Sponsor: Consorci Mar Parc De Salut De Barcelona (Hospital/Clinic/Other health care facility). Phase: Therapeutic use (Phase IV). Countries: Spain (authorised, recruitment pending).
Therapeutic area(s): Diseases [C] - Cardiovascular Diseases [C14]
Gender: Female, Male. Age: 18-64 years, 65+ years. Enrolment: 102.
Status: Authorised, recruitment pending. Decision date: 2025-09-02. Results received: No. Last updated: 2026-03-20.

Condition(s): Patients with diagnosis of Pulmonary Arterial Hypertension of the following types according to 2022 ERS/ESC guidelines: idiopathic, hereditary, drug- and toxin-induced PAH or associated to connective tissues disease
Product: ALPHA-TOCOPHEROL, TRIGLYCERIDES MEDIUM CHAIN, CALCIFEDIOL

Primary endpoint: Efficacy outcome: clinical improvement and no clinical worsening.
Endpoint(s): Safety of the intervention: Serum 25(OH) vitD concentration, Six minute walk text (6MWD), Plasmatic levels of N-terminal pro b-type natriuretic peptide (NT-proBNP), Functional class (WHO/NYAS), Estimated pulmonary systolic pressure (PASP), TAPSE/PASP: the ratio of Tricuspid Annular Plane Systolic Excursion (TAPSE) to Pulmonary Arterial Systolic Pressure (PASP), Serum noggin protein level., Non-invasive risk score (NIRS) (FC,6MWT and NT-proBNP)., Quality of life (emPHasis-10)., Adverse effects.

Source: https://euclinicaltrials.eu/ctis-public/view/2025-521694-14-00